EU clinical trial 2024-514562-40-00: Phase 2, Randomized, Double-blind, Placebo-controlled, Parallel-group Study to Evaluate the Efficacy and Safety of AVTX-009 in Patients with Moderate to Severe Hidradenitis Suppurativa (LOTUS)
Protocol code: AVTX-009-HS-201
Sponsor: Avalo Therapeutics Inc. (Pharmaceutical company). Phase: Therapeutic exploratory (Phase II). Countries: France (ended), Italy (ended), Bulgaria (ended), Greece (ended), Slovakia (ended), Germany (ended), Czechia (ended), Poland (ended), Spain (ended).
Therapeutic area(s): Diseases [C] - Skin and Connective Tissue Diseases [C17]
Gender: Female, Male. Age: 18-64 years, 65+ years. Enrolment: 243.
Status: Ended. Start date (EU): 2025-03-13. End date (EU): 2026-03-17. End date: 2026-03-18. Decision date: 2025-01-31. Results received: No. Last updated: 2026-03-17.
Decision dates by country: DE: 2025-02-04, IT: 2025-02-04, PL: 2025-02-10, ES: 2025-02-05, GR: 2025-04-01, SK: 2025-02-05, CZ: 2025-02-05, FR: 2025-02-03, BG: 2025-02-05

Condition(s): Hidradenitis suppurativa (HS)
Product: Placebo to AVTX-009, AVTX-009

Primary endpoint: The proportion of subjects achieving Hidradenitis suppurativa Clinical Response 75 (HiSCR75) at Week 16 defined as: - At least a 75% reduction in the total abscess and inflammatory nodule (AN) count, with no increase in abscess count and no increase in draining fistula count relative to Baseline
Endpoint(s): Incidence of adverse events (AEs), and changes from Baseline in vital signs, physical examinations, and clinical laboratory tests, The proportion of subjects achieving HiSCR50 by visit defined as: - At least a 50% reduction in the total AN count, with no increase in abscess count and no increase in draining fistula count relative to Baseline, The proportion of subjects achieving HiSCR90 by visit defined as: - At least a 90% reduction in the total AN count, with no increase in abscess count and no increase in draining fistula count relative to Baseline, Change from Baseline in International HS Severity Score System (IHS4), Change from Baseline in AN count, Change from Baseline in draining fistula count, Percentage of subjects achieving at least a 30% reduction and at least a 1-unit reduction from Baseline on a Numerical Rating Scale (NRS) in Patient’s Global Assessment of Skin Pain (PGA Skin Pain) among subjects with Baseline NRS ≥3 (NRS30). NRS30 is based on worst skin pain in a 24-hour recall period (maximal daily pain), Percentage of subjects with flares defined as ≥25% increase in AN count plus an increase of ≥2 in AN count compared to Baseline, Incidence of AVTX-009 anti-drug antibodies (ADA) at specified timepoints

Source: https://euclinicaltrials.eu/ctis-public/view/2024-514562-40-00